EU clinical trial 2023-505321-14-00: Efficacy and Safety of M281 in Adults with Warm Autoimmune Hemolytic Anemia: A Multicenter, Randomized, Double blind, Placebo controlled Study with a Long-term Open-label Extension
Protocol code: MOM-M281-006
Sponsor: Janssen - Cilag International (Pharmaceutical company). Phase: Phase II and Phase III (Integrated). Countries: Hungary (ended), Czechia (ongoing, recruitment ended), France (ongoing, recruitment ended), Greece (ended), Netherlands (ongoing, recruitment ended), Poland (ongoing, recruitment ended), Spain (ongoing, recruitment ended), Italy (ongoing, recruitment ended), Germany (ended).
Therapeutic area(s): Diseases [C] - Immune System Diseases [C20]
Gender: Female, Male. Age: 18-64 years, 65+ years. Enrolment: 51.
Start date (EU): 2019-09-06. Decision date: 2024-02-08. Results received: No. Last updated: 2026-07-06.
Decision dates by country: GR: 2024-04-15, PL: 2024-02-20, DE: 2024-02-13, IT: 2024-03-11, FR: 2024-02-15, CZ: 2024-02-09, ES: 2024-02-08, NL: 2024-02-09, HU: 2024-02-09

Condition(s): Warm Autoimmune Hemolytic Anemia
Product: JNJ-80202135, Isotone Natriumchloridlösung 0,9 % Braun Injektionslösung, JNJ-80202135

Primary endpoint: The primary efficacy endpoint is durable response in improvement of Hgb, defined as the attainment of the following at 3 consecutive visits (minimum duration 28 days), where at least the first is at or before Week 16, without the need of rescue therapy: • Hgb concentration ≥10 g/dL AND • An increase from baseline in Hgb ≥2 g/dL The first of the three consecutive visits must be at or before week 16 of the double-blind period in order to qualify for success in the primary efficacy endpoint., (Cont.) For example, if a participant attained the above criteria at weeks 18, 20, and 22 and not before, this participant would not be considered a success. If the participant attained the criteria at weeks 16, 18, and 20, the patient would be considered a success. Participants who took rescue therapy before reaching the criteria will be treated as having failed the primary efficacy outcome., (Cont.) . If a participant has missing Hgb at both screening and baseline but is randomized by mistake, the participant will be excluded from the ITT analysis. This situation is unlikely to happen because the IVRS system requires screening Hgb for randomization to occur

Source: https://euclinicaltrials.eu/ctis-public/view/2023-505321-14-00